EU clinical trial 2024-515875-36-00: SEVILLA_A randomised, phase II trial to evaluate the efficacy of ivonescimab, a PD 1/VEGF bispecific antibody, versus FOLFOX as second line therapy for locally advanced or metastatic biliary tract cancers
Protocol code: UC-GIG-2404
Sponsor: Unicancer (Hospital/Clinic/Other health care facility). Phase: Therapeutic exploratory (Phase II). Countries: France (ongoing, recruiting).
Therapeutic area(s): Diseases [C] - Neoplasms [C04]
Gender: Female, Male. Age: 18-64 years, 65+ years. Enrolment: 42.
Status: Ongoing, recruiting. Start date (EU): 2025-08-18. Decision date: 2025-03-10. Results received: No. Last updated: 2026-07-10.

Condition(s): Advanced biliary tract cancer (BTC)
Product: FLUOROURACIL, OXALIPLATIN, ivonescimab, CALCIUM LEVOFOLINATE, CALCIUM FOLINATE

Primary endpoint: Progression-free survival, defined as the time from randomisation to the first documented progression of disease (PD) as assessed by the investigator according to RECIST v1.1, or death from any cause, whichever occurs first. Patients who are alive and have not progressed at the time of the analysis will be censored at their last evaluable tumour assessment
Endpoint(s): Overall survival (OS), defined as the time from randomisation to death due to any cause. Patients still alive at the cut-off time (including lost to follow-up) will be censored at the last date they are known to be alive., Disease control rate, defined as the proportion of randomised patients achieving CR, PR, or stable disease (SD) as assessed by the investigator according to RECIST v1.1., Objective response rate, defined as the proportion of randomised patients achieving complete response (CR) or partial response (PR) as assessed by the investigator according to RECIST v1.1., Duration of response, defined as the time from first documented PR or CR (compared to baseline measurement taken at randomisation) until the date of PD, as assessed by the investigator according to RECIST v1.1, or death from any cause whichever occurs first. Patients who are alive and have not progressed at the time of the analysis will be censored at their last evaluable tumour assessment., Toxicity / adverse events, evaluated according to NCI-CTCAE v5.0., Treatment compliance will be reported by presenting reasons for reasons for treatment delays, dose omissions, dose reductions and treatment discontinuation., Health-Related quality of life assessed using the European Organisation for Research and Treatment of Cancer (EORTC) quality of life questionnaires QLQ-C30 and QLQ-BIL21, Time until definitive deterioration of quality of life (TTUD), defined as the time from randomisation to the first observation of a definitive deterioration of EORTC QLQ-C30 score., Quality of life adjusted- survival (QAS), derived from responses to the EORTC QLQ C30 questionnaire and OS data.

Source: https://euclinicaltrials.eu/ctis-public/view/2024-515875-36-00